EU clinical trial 2024-519527-14-00: Multicenter, double-blind, randomized, placebo-controlled phase III clinical trial in parallel groups which evaluates the clinical efficacy and safety of immunotherapy with the purified major allergen Cup a 1, in patients with moderate/severe allergic rhino conjunctivitis with or without controlled asthma, sensitized to Cupressaceae
Protocol code: DIA-EC-Cupa1-01-22
Sponsor: Diater Laboratorio De Diagnostico Y Aplicaciones Terapeuticas S.A. (Pharmaceutical company). Phase: Therapeutic confirmatory (Phase III). Countries: Spain (ended).
Therapeutic area(s): Diseases [C] - Immune System Diseases [C20]
Gender: Female, Male. Age: 0-17 years, 18-64 years, 65+ years. Enrolment: 150.
Status: Ended. Start date (EU): 2022-06-09. End date (EU): 2025-05-07. Decision date: 2024-12-19. Results received: Yes. Last updated: 2024-12-19.

Condition(s): Allergic rhinoconjunctivitis
Product: The appareance, packaged, interval, route and method of administration for placebo will be the same as IMP. The composition of the placebo is 0.9% saline solution with mannitol + histamine., Cup a 1, Cup a 1

Primary endpoint: The efficacy of the treatment will be evaluated based on the symptom frequency and severity score together with the Combined Symptom and Medication Score (CSMS), which will be obtained through a questionnaire completed by the patient during 2 successive pollen seasons
Endpoint(s): Symptom frequency and severity score. Results are compared between treatment arms and between pollen seasons, Score for Rescue medication use, Symptom-free days, Medication-free days, Extra visits and/or emergencies during the period of the clinical trial related to the pathology under study, Skin follow-up skin test with Cupressaceae extract and Cup a 1, Asthma and allergic rhinitis control assessed by ACT and modified ARIA, Visual Analog Scale (VAS) for the state of health performed by the patient, ESPRINT-15 questionnaire evaluation, Evaluation of immunological markers: IL-10, IL-13, INF-ƴ, specific IgE and specific IgG4 against Cupressus arizonica and Cup a 1, Conjunctival provocation against cupresaceae, Frequency of adverse events (AEs), serious AAs (SAEs) and ADRs, particularly systemic events according to the World Allergy Organization (WAO) 2010 classification

Source: https://euclinicaltrials.eu/ctis-public/view/2024-519527-14-00